EU clinical trial 2023-508516-34-00: Effect of Camostat for Kidney Protection in Chronic Kidney Disease (CamKid).
Sponsor: Odense University Hospital (Hospital/Clinic/Other health care facility). Phase: Therapeutic exploratory (Phase II). Countries: Denmark (ended).
Therapeutic area(s): Diseases [C] - Cardiovascular Diseases [C14]
Gender: Female, Male. Age: 18-64 years, 65+ years. Enrolment: 40.
Status: Ended. Start date (EU): 2024-10-30. End date (EU): 2026-02-27. Decision date: 2024-03-18. Results received: No. Last updated: 2025-12-22.

Condition(s): Chronic Kidney Disease with proteinuria
Product: CAMOSTAT MESILATE

Primary endpoint: Urine sodium excretion, Water excretion, Body Composition Monitor / weight, Home blood pressure
Endpoint(s): Urine protease activity: zymography + protease activity assay, Tubular complement activation: Urine total C3, C3a, C5a, MAC-sC5b-9, C3dg, MBL, Urine microvesicles: gammaENaC cleavage and complement deposition (sC5b-9), 24 hours urine albumin excretion, Plasma concentration of renin, NT-proBNP, angiotensin II and aldosterone

Source: https://euclinicaltrials.eu/ctis-public/view/2023-508516-34-00